EU clinical trial 2024-511575-15-00: Pred Forte® versus placebo eye drops in chronic central serous chorioretinopathy trial (PICS trial)
Sponsor: Stichting Radboud University Medical Center (Patient organisation/association). Phase: Therapeutic confirmatory (Phase III). Countries: Netherlands (ongoing, recruiting).
Therapeutic area(s): Diseases [C] - Eye Diseases [C11]
Gender: Female, Male. Age: 18-64 years, 65+ years. Enrolment: 40.
Status: Ongoing, recruiting. Start date (EU): 2025-01-29. Decision date: 2025-01-28. Results received: No. Last updated: 2025-01-28.

Condition(s): Central serous chorioretinopathy
Product: DURATEARS, oogdruppels, Pred Forte 1,0 % oogdruppels, suspensie

Primary endpoint: Change in sub- and intraretinal fluid on OCT scan: The primary outcome measure of this study is the effect of steroid eye drops in cCSC on the amount of sub and intraretinal fluid. The difference in the amount of sub- and intraretinal fluid will be compared between the OCT scan made prior to the study and the OCT scan made at the second consultation after the study medication has been used for four weeks.

Source: https://euclinicaltrials.eu/ctis-public/view/2024-511575-15-00